EU clinical trial 2023-510415-19-00: PHASE II STUDY OF AZACITIDINE IN COMBINATION WITH LOW DOSE INTENSITY VENETOCLAX IN PATIENTS WITH ACUTE MYELOID LEUKEMIA WITH INTEGRATION OF EXPLORATIVE MULTI-OMICS AND EX VIVO DRUG SCREENING DATA
Sponsor: Rigshospitalet (Hospital/Clinic/Other health care facility). Phase: Therapeutic exploratory (Phase II). Countries: Norway (ongoing, recruiting), Sweden (ongoing, recruiting), Denmark (ongoing, recruiting), Finland (ongoing, recruiting).
Therapeutic area(s): Diseases [C] - Hemic and Lymphatic Diseases [C15]
Gender: Female, Male. Age: 18-64 years, 65+ years. Enrolment: 147.
Status: Ongoing, recruiting. Start date (EU): 2024-08-28. Decision date: 2024-08-28. Results received: No. Last updated: 2026-04-30.
Decision dates by country: FI: 2024-08-28, NO: 2024-08-29, DK: 2024-08-28, SE: 2024-08-28

Condition(s): Acute Myeloid Leukemia
Product: AZACITIDINE, VENETOCLAX, Inaqovi 35 mg/100 mg film-coated tablets

Primary endpoint: ORR (including CR/CRh/CRi/MLFS rate, composite CR/CRh/CRi rate, PR rate).
Endpoint(s): Overall survival (OS), duration of response (DOR), progression free survival (PFS)., Frequency and severity of adverse events (hematologic toxicities-AE grade 3+4, febrile neutropenia, days until neutrophil recovery ≥ 0.5 x 10E9/l and platelet recovery ≥ 50 x 10E9/l, severe AE grade 3+4).

Source: https://euclinicaltrials.eu/ctis-public/view/2023-510415-19-00